EU clinical trial 2024-517613-33-00: A two-center, randomized, double-blind, placebo-controlled study of intravenous plasma-purified alpha-1 antitrypsin for hospitalized patients with COPD exacerbations (AECOPD study)
Protocol code: AECOPD
Sponsor: Fondazione IRCCS Policlinico San Matteo (Hospital/Clinic/Other health care facility). Phase: Therapeutic exploratory (Phase II). Countries: Italy (ongoing, recruiting).
Therapeutic area(s): Diseases [C] - Respiratory Tract Diseases [C08]
Gender: Female, Male. Age: 18-64 years, 65+ years. Enrolment: 36.
Status: Ongoing, recruiting. Start date (EU): 2025-10-16. Decision date: 2025-03-04. Results received: No. Last updated: 2025-10-13.

Condition(s): Chronic Obstructive Pulmonary Disease
Product: Sodio Cloruro DIACO 0,9% Soluzione per infusione, Prolastin 1000 mg, polvere e solvente per soluzione per infusione

Primary endpoint: Change in plasma concentration of IL-6 at 7 days after randomization
Endpoint(s): Change in plasma concentration of IL-1b, IL-5, IL-8, IL-10, and soluble TNF receptor 1(sTNFR1), CRP at 7 days after randomization, Treatment failure (need for either NIV or CPAP or ETI or transfer to ICU or in-hospital death after randomization), Differences in SGRQ score at discharge

Source: https://euclinicaltrials.eu/ctis-public/view/2024-517613-33-00